EU clinical trial 2024-512482-14-00: A Phase 2a, Randomized, Open-Label Study to Evaluate the Efficacy, Safety, Tolerability, Pharmacokinetics, and Pharmacodynamics of ISIS 702843 Administered to Patients with Phlebotomy Dependent Polycythemia Vera (PD-PV)
Protocol code: ISIS702843-CS4
Sponsor: Ionis Pharmaceuticals Inc. (Pharmaceutical company). Phase: Therapeutic exploratory (Phase II). Countries: Poland (ended).
Therapeutic area(s): Diseases [C] - Hemic and Lymphatic Diseases [C15]
Gender: Female, Male. Age: 18-64 years, 65+ years. Enrolment: 10.
Status: Ended. Start date (EU): 2023-06-21. End date (EU): 2026-05-13. End date: 2026-06-02. Decision date: 2024-07-10. Results received: No. Last updated: 2026-04-07.

Condition(s): Polycythemia Vera
Product: ISIS 702843

Primary endpoint: Reduction in the frequency of phlebotomy comparing Baseline with the last 20 weeks of the 37-week Treatment Period
Endpoint(s): Proportion of patients achieving a reduction in the frequency of phlebotomy by ≥ 30%, ≥ 50%, ≥ 75% and ≥ 90% comparing Baseline with the last 20 weeks of the 37-week Treatment Period [ Time Frame: Week 17 to Week 37 ], Change in the Myeloproliferative Neoplasm Symptom Assessment Form-Total Symptom Score (MPN-SAF-TSS) From Baseline to Week 37 [ Time Frame: Baseline up to Week 37 ], Safety Endpoint: AEs, vital signs, clinical laboratory tests (serum chemistry, hematology, urinalysis, coagulation panel, thyroid panel [TSH, T3, T4], electrocardiogram [ECG], Exploratory Endpoints: Proportion of patients achieving Hct control (i.e. Hct<45%) without receiving phlebotomy throughout the last 20 weeks of the 37-week Treatment Period, Exploratory Endpoints: Reduction in the frequency of phlebotomy comparing Baseline to the last 36 Weeks of the Treatment Extension Period, Exploratory Endpoints: Proportion of patients achieving Hct control (i.e., Hct<45%) without receiving phlebotomy from Week 37 to 73 of the Treatment Extension Period, PK Endpoint: A PK profile including pre-dose, 1,2,4, and optional 6-hour samples will be collected at Day 1. A PK profile will also be collected at Week 25 and will include: pre-dose, 1-, 2-, and 3-hour samples. Trough levels will be evaluated at all clinic visits at will not be required for hom health care visits.

Source: https://euclinicaltrials.eu/ctis-public/view/2024-512482-14-00